EU clinical trial 2023-509716-29-00: A Phase 1a/1b Study of ELVN-002 Combined with Trastuzumab in Advanced Stage HER2+ Solid tumors, and ELVN-002 Combined with Trastuzumab and Chemotherapy in Advanced Stage HER2+ Colorectal Cancer and Breast Cancer
Protocol code: ELVN-002-003
Sponsor: Enliven Therapeutics Inc. (Pharmaceutical company). Phase: Phase I and Phase II (Integrated)- Other. Countries: Netherlands (ended), France (ended), Italy (ended), Spain (ended), Belgium (ended).
Therapeutic area(s): Diseases [C] - Neoplasms [C04]
Gender: Female, Male. Age: 18-64 years, 65+ years. Enrolment: 156.
Status: Ended. Start date (EU): 2024-09-23. End date (EU): 2026-06-26. End date: 2026-06-27. Decision date: 2024-08-14. Results received: No. Last updated: 2025-11-24.
Decision dates by country: NL: 2024-08-16, IT: 2024-09-26, ES: 2024-09-20, BE: 2024-08-20, FR: 2024-08-20

Condition(s): Solid Tumors, Colorectal Cancer and Breast Cancer
Product: 5-FU medac 50 mg/ml, Injektionslösung, ELVN-002, BENDAFOLIN 10 mg/ml Injektionslösung, ELVN-002, ELVN-002, ELVN-002, ELVN-002, Benda-5 FU 50 mg/ml Injektionslösung, Oxaliplatin AqVida 5 mg/ml Konzentrat zur Herstellung einer Infusionslösung, ELVN-002, Paclitaxel AqVida 6 mg/ml Konzentrat zur Herstellung einer Infusionslösung, HALAVEN 0.44 mg/ml solution for injection, Capecitabin "Zentiva", filmovertrukne tabletter, ELVN-002, Herceptin 150 mg powder for concentrate for solution for infusion, Capecitabine Accord 150 mg film-coated tablets

Primary endpoint: Phase 1a: ELVN-002 + Trastuzumab: • Incidence of dose limiting toxicities (DLTs), Phase 1a: ELVN-002 + Trastuzumab: • Incidence of adverse events (AEs), laboratory abnormalities, and electrocardiogram (ECG) abnormalities, Phase 1a: ELVN-002 + Trastuzumab + Chemotherapy: • Incidence of dose limiting toxicities (DLTs), Phase 1a: ELVN-002 + Trastuzumab + Chemotherapy: • Incidence of dose limiting toxicities (DLTs), Phase 1a: ELVN-002 + Trastuzumab + Chemotherapy: • Incidence of adverse events (Aes), laboratory abnormalities, and electrocardiogram (ECG) abnormalities
Endpoint(s): Phase 1a: ELVN-002 plasma concentrations and PK parameters, including: area under the curve (AUC), maximum concentration (Cmax), timeat which Cmax is observed (Tmax), minimum concentration (Cmin), terminal half-life (T1/2), and other parameters such as dose proportionality and accumulation ratio, Phase 1a: Confirmed ORR as assessed by investigators per RECIST v1.1, Phase 1b: Confirmed ORR and DOR as assessed by ICR per RECIST v1.1, Phase 1b: Brain metastases response, Phase 1b: ELVN-002 plasma concentrations

Source: https://euclinicaltrials.eu/ctis-public/view/2023-509716-29-00